EU clinical trial 2024-513372-18-00: Palbociclib plus fulvestrant in women with hormone receptor positive and human epidermal growth factor receptor type 2 negative locally advanced or metastatic breast cancer previously treated with a CDK4/6 inhibitor in combination with hormonal therapy: a multicenter, phase II trial
Protocol code: GIM24-PALBO-BP
Sponsor: Consorzio Oncotech (Pharmaceutical company). Phase: Therapeutic exploratory (Phase II). Countries: Italy (ongoing, recruiting).
Therapeutic area(s): Diseases [C] - Neoplasms [C04]
Gender: Female. Age: 18-64 years, 65+ years. Enrolment: 168.
Status: Ongoing, recruiting. Start date (EU): 2019-10-18. Decision date: 2024-05-29. Results received: No. Last updated: 2024-05-29.

Condition(s): Pre- and post-menopausal women with HR+/HER2- LABC or MBC whose disease has progressed to CDK4/6 inhibitor in combination with a hormonal therapy in the adjuvant or metastatic setting
Product: IBRANCE 125 mg hard capsules, IBRANCE 125 mg film-coated tablets, IBRANCE 100 mg film-coated tablets, IBRANCE 100 mg hard capsules, IBRANCE 75 mg hard capsules, IBRANCE 75 mg film-coated tablets

Primary endpoint: To evaluate the efficacy of the combination of fulvestrant plus palbociclib at the progression of a combined treatment of hormonal therapy (aromatase inhibitor or tamoxifen ± LHRHa) and CDK4/6 inhibitors with respect to: • Overall response rate (ORR) • Progression Free Survival (PFS) • 6-month PFS rate • Overall Survival (OS) • Safety and tolerability
Endpoint(s): To assess predictive biomarkers of response/resistance to fulvestrant plus palbociclib using metastatic tumor tissue samples and liquid biopsies.

Source: https://euclinicaltrials.eu/ctis-public/view/2024-513372-18-00